EU clinical trial 2023-510544-21-00: INtra-tumor miCro dosIng in PatIents with advanced malignant mElanoma receiving aNti-PD1 Therapy. A pilot study.
Protocol code: S68579
Sponsor: UZ Leuven (Hospital/Clinic/Other health care facility). Phase: Human Pharmacology (Phase I)- Other. Countries: Belgium (ongoing, recruiting).
Therapeutic area(s): Diseases [C] - Skin and Connective Tissue Diseases [C17]
Gender: Female, Male. Age: 18-64 years, 65+ years. Enrolment: 4.
Status: Ongoing, recruiting. Start date (EU): 2025-02-18. Decision date: 2024-08-14. Results received: No. Last updated: 2026-06-18.

Condition(s): Malignant Melanoma

Source: https://euclinicaltrials.eu/ctis-public/view/2023-510544-21-00